EU clinical trial 2025-522451-25-00: PROBHE: Prehabilitation with Botulinum Toxin A in complex hernia: an Italian prospective study on predictive scores of myofascial release.
Protocol code: PRoBHe
Sponsor: Azienda Socio Sanitaria Territoriale Ovest Milanese (Hospital/Clinic/Other health care facility). Phase: Therapeutic exploratory (Phase II). Countries: Italy (ongoing, recruiting).
Therapeutic area(s): Analytical,Diagnostic,Therapeutic Techniques and Equipment [E]-Surgical Procedures, Operative [E04]
Gender: Female, Male. Age: 18-64 years, 65+ years. Enrolment: 1.
Status: Ongoing, recruiting. Start date (EU): 2026-02-17. Decision date: 2025-11-04. Results received: No. Last updated: 2026-02-17.

Condition(s): Large hernia width, chronically retracted lateral abdominal wall muscles, and irreducible visceral content in the hernia
Product: Botulinum Toxin Type A 500 units Powder for solution for injection

Primary endpoint: RDR is the ratio between the sum of the width of two recti to defect width. According to Love et al., with each increase of 0.5 in the RDR value, a linear decrease in the need for AMR of approximately 20% is achieved., CSI is calculated choosing a fixed point on a preoperative axial computed tomographic (CT) scan (aorta) and the medial leading edges of the rectus abdominus muscles. A CSI > 0.146 is a predictive score of myofascial release, Hernia width, LM length and width, and abdominal volume and diameters will also be measured. A hernia width > 10 cm is a predictive score of myofascial release
Endpoint(s): • PBR is defined as % of peritoneal sac needed to achieve complete posterior fascial closure. It is the ratio between the area of peritoneal sac and the area of the posterior plane, obtained during the preperitoneal/pre-transversalis dissection, • ABR is defined as % of peritoneal sac needed to achieve complete anterior fascial closure. It is the ratio between the area of the peritoneal sac and the area of the anterior plane, obtained during the subcutaneous dissection, When a PCS with TAR is performed, different percentage of ABR e PBR may correlate with efficacy outcomes of BTA injection:

Source: https://euclinicaltrials.eu/ctis-public/view/2025-522451-25-00